EU clinical trial 2023-507031-38-00: A Phase III, Multicentre, Randomised, Double-blind, Parallel-group, Placebo-controlled Study to Evaluate the Efficacy and Safety of Tozorakimab (MEDI3506) in Patients Hospitalised for Viral Lung Infection Requiring Supplemental Oxygen (TILIA)
Protocol code: D9185C00001
Sponsor: Astrazeneca AB (Pharmaceutical company). Phase: Therapeutic confirmatory (Phase III). Countries: France (ongoing, recruiting), Sweden (ongoing, recruiting), Bulgaria (ended), Romania (ended), Greece (ongoing, recruiting), Italy (ongoing, recruiting), Germany (ongoing, recruiting), Spain (ended), Czechia (ongoing, recruiting), Poland (ongoing, recruiting), Denmark (ongoing, recruiting), Slovakia (ended), Belgium (ongoing, recruiting), Hungary (ongoing, recruiting).
Therapeutic area(s): Diseases [C] - Respiratory Tract Diseases [C08]
Gender: Female, Male. Age: 18-64 years, 65+ years. Enrolment: 828.
Start date (EU): 2023-01-09. Decision date: 2024-02-16. Results received: No. Last updated: 2026-07-27.
Decision dates by country: SK: 2024-05-30, DE: 2024-02-20, DK: 2024-02-16, FR: 2024-02-16, BG: 2024-03-07, RO: 2024-02-21, PL: 2024-06-10, ES: 2024-02-21, GR: 2024-04-01, CZ: 2024-02-19, SE: 2024-02-19, BE: 2024-02-22, IT: 2024-03-15, HU: 2024-05-14

Condition(s): Severe viral lung infections
Product: Tozorakimab, Tozorakimab-placebo

Primary endpoint: Proportion of participants who die or progress to IMV/ECMO by Day 28
Endpoint(s): 1. Proportion of participants who die by Day 60, 2. Number of days alive and outside of ICU over 28 day period, 3. Number of days alive and free of supplemental oxygen over 28 day period, 4. Time to death or progression to IMV/ECMO, 5. Proportion of participants who die or progress to IMV/ECMO by Day 60, 6. Time to death (all cause), 7. Proportion of participants who die by Day 28, 8. Number of days alive and free of IMV/ECMO over 28 day and 60 day period, 9. Number of days alive and ventilator free over 28 day and 60 day period, 10. Proportion of participants with ICU admission or death by Day 28 and Day 60, 11. Proportion of participants alive and discharged by Day 28 and Day 60, 12. Time to discharge, 13. Time to being off supplemental oxygen, 14. WHO CPS score rank-based comparison, 15. Presence of anti-drug antibodies, 16. Baseline serum biomarker levels relative to primary endpoint

Source: https://euclinicaltrials.eu/ctis-public/view/2023-507031-38-00